EU clinical trial 2023-506572-27-00: A PHASE 1, OPEN-LABEL, DOSE ESCALATION AND DOSE EXPANSION STUDY OF CLN-049 FOR THE TREATMENT OF ACUTE MYELOID LEUKEMIA (AML) PATIENTS WITH MEASURABLE RESIDUAL DISEASE (MRD)
Protocol code: CLN-049-002
Sponsor: Florentine Cullinan Corp. (Pharmaceutical company). Phase: Human Pharmacology (Phase I)- Other. Countries: Germany (ongoing, recruiting), Spain (ongoing, recruiting).
Therapeutic area(s): Diseases [C] - Neoplasms [C04]
Gender: Female, Male. Age: 18-64 years, 65+ years. Enrolment: 97.
Status: Ongoing, recruiting. Start date (EU): 2024-01-12. Decision date: 2023-11-21. Results received: No. Last updated: 2026-07-22.
Decision dates by country: ES: 2024-09-23, DE: 2023-11-21

Condition(s): Acute Myeloid Leukemia (AML) with Measurable Residual Disease (MRD)

Source: https://euclinicaltrials.eu/ctis-public/view/2023-506572-27-00